EU clinical trial 2022-501531-16-00: A Randomized, Double-blind, Placebo-controlled Phase 3 Trial of Pembrolizumab (MK-3475) Versus Placebo in Participants with Esophageal Carcinoma Receiving Concurrent Definitive Chemoradiotherapy (KEYNOTE 975)
Protocol code: MK-3475-975
Sponsor: Merck Sharp & Dohme LLC (Pharmaceutical company). Phase: Therapeutic confirmatory (Phase III). Countries: Portugal (ended), Estonia (ended), Romania (ended), France (ended), Italy (ended), Germany (ended), Denmark (ended), Belgium (ended), Hungary (ended), Czechia (ended).
Therapeutic area(s): Diseases [C] - Digestive System Diseases [C06]
Gender: Female, Male. Age: 18-64 years, 65+ years. Enrolment: 191.
Status: Ended. Start date (EU): 2020-01-24. End date (EU): 2026-06-22. End date: 2026-06-26. Decision date: 2023-03-14. Results received: No. Last updated: 2026-05-05.
Decision dates by country: CZ: 2023-10-19, IT: 2023-03-14, DK: 2023-03-14, RO: 2023-03-20, PT: 2023-03-15, HU: 2023-03-16, BE: 2023-03-17, EE: 2023-03-20, DE: 2023-03-16, FR: 2023-03-20

Condition(s): esophageal carcinoma
Product: Placebo to Keytruda - saline, CALCIUM LEVOFOLINATE, KEYTRUDA 25 mg/mL concentrate for solution for infusion, FLUOROURACIL, OXALIPLATIN, CALCIUM FOLINATE, CISPLATIN, FOLINIC ACID

Primary endpoint: Overall Survival (OS), Event-free Survival (EFS)
Endpoint(s): Number of participants with an adverse event (AE), Number of participants discontinuing study treatment due to an adverse event (AE)

Source: https://euclinicaltrials.eu/ctis-public/view/2022-501531-16-00